EU clinical trial 2024-518216-39-00: Combination Therapy with Interferon-Alpha2a and Ruxolitinib in Newly Diagnosed Patients with Polycythemia Vera. A Danish Safety and Efficacy Study.
Protocol code: 30032016
Sponsor: Region Sjaelland (Hospital/Clinic/Other health care facility). Phase: Therapeutic exploratory (Phase II). Countries: Denmark (authorised, recruitment pending).
Therapeutic area(s): Diseases [C] - Hemic and Lymphatic Diseases [C15]
Gender: Female, Male. Age: 18-64 years, 65+ years. Enrolment: 25.
Status: Authorised, recruitment pending. Decision date: 2024-11-04. Results received: No. Last updated: 2024-11-04.

Condition(s): Polycythemia
Product: PEGINTERFERON ALFA-2A, Jakavi 5 mg tablets

Primary endpoint: Safety Profile: relevant adverse events (AE), serious AEs (SAE), withdrawal due to AEs/SAE
Endpoint(s): 1. Safety Profile: adverse events (AE), serious AEs (SAE), withdrawal, AEs/SAEs 2. Efficacy Profile: a) Proportion of patients achieving complete hematological remission (HCT < 45, PLA ≤400 and WBC < 10) after 3, 6, 8, 9, 12, 18 and 24 months. b) Remission rates at 12 and 24 months. c) JAK2V617F allele burden measured at baseline and after 3,6,12 and 24 months. d) Proportion of patients suffering thrombosis and/or hemorrhage at 12 at 24 months. with more e)-j)

Source: https://euclinicaltrials.eu/ctis-public/view/2024-518216-39-00